EU clinical trial 2023-506201-19-00: A Long-term, Open-label Extension Study of Carbetocin Nasal Spray for the Treatment of Hyperphagia in Prader-Willi Syndrome
Protocol code: ACP-101-303
Sponsor: Acadia Pharmaceuticals Inc. (Pharmaceutical company). Phase: Therapeutic confirmatory (Phase III). Countries: Germany (ended), Spain (ended), France (ended).
Therapeutic area(s): Diseases [C] - Congenital, Hereditary, and Neonatal Diseases and Abnormalities [C16]
Gender: Female, Male. Age: 0-17 years, 18-64 years. Enrolment: 48.
Status: Ended. Start date (EU): 2025-04-28. End date (EU): 2025-11-28. End date: 2025-12-19. Decision date: 2025-03-05. Results received: Yes. Last updated: 2025-09-16.
Decision dates by country: ES: 2025-03-17, FR: 2025-03-17, DE: 2025-03-17

Condition(s): Hyperphagia related behaviour associated with Prader-Willi Syndrome (PWS)
Product: Carbetocin Nasal Spray

Primary endpoint: Treatment-emergent adverse events (TEAEs), Serious adverse events (SAEs), Withdrawals due to adverse events (AEs), Potentially clinically important changes in other safety assessments, Device incidents, or device malfunctions
Endpoint(s): Hyperphagia Questionnaire for Clinical Trials (HQ-CT) score – change from Baseline at each visit, Clinical Global Impression–Severity (CGI-S) for PWS score – change from Baseline at each visit, Percentage of subjects with treatment response based on the HQ-CT (defined as improvement from Baseline ≥8 points) at each visit, PWS Anxiousness and Distress Behaviors Questionnaire (PADQ) score – change from Baseline at each visit, Clinical Global Impression – Change (CGI-C) for PWS score at each visit, CGI-S for hyperphagia in PWS score – change from Baseline at each visit, Food Safe Zone score – change from Baseline at each visit, Zarit Burden Interview (ZBI) score – change from Baseline at each visit, PWS-specific Healthcare Resource Use and Caregiver Burden Questionnaire (PWS-HRUQ) – change from Baseline at each visit

Source: https://euclinicaltrials.eu/ctis-public/view/2023-506201-19-00